EU clinical trial 2024-515905-25-00: J5P-MC-GZRA: A Master Protocol to Investigate the Efficacy and Safety of Orforglipron Once Daily in Participants Who Have Obstructive Sleep Apnea and Obesity or Overweight: A Randomized, Double-Blind, Placebo-Controlled Trial (ATTAIN-OSA); J5P-MC-GZ01: Participants with OSA unable or unwilling to use PAP therapy; J5P-MC-GZ02: Participants with OSA on PAP therapy
Protocol code: J5P-MC-GZRA
Sponsor: Eli Lilly & Co. (Pharmaceutical company). Phase: Therapeutic confirmatory (Phase III). Countries: Czechia (ended), Germany (ended).
Therapeutic area(s): Diseases [C] - Respiratory Tract Diseases [C08]
Gender: Female, Male. Age: 18-64 years, 65+ years. Enrolment: 118.
Status: Ended. Start date (EU): 2025-01-29. End date (EU): 2026-07-29. End date: 2026-07-30. Decision date: 2025-01-14. Results received: No. Last updated: 2025-06-26.
Decision dates by country: CZ: 2025-01-24, DE: 2025-01-14

Condition(s): Overweight or Obesity, OSA (Obstructive Sleep Apnea)
Product: Placebo to match LY

Primary endpoint: Change from Baseline in Apnea-Hypopnea Index (AHI) [Time Frame: Baseline to Week 52]

Source: https://euclinicaltrials.eu/ctis-public/view/2024-515905-25-00